EU clinical trial 2024-516773-69-00: Evaluation of the safety and efficacy of Berubicin in the treatment of central nervous system lymphomas- BERUBICIN
Protocol code: BER-PUM-01
Sponsor: Pomeranian Medical University (Educational Institution). Phase: Phase I and Phase II (Integrated)- Other. Countries: Poland (ended).
Therapeutic area(s): Diseases [C] - Neoplasms [C04]; Diseases [C] - Nervous System Diseases [C10]
Gender: Female, Male. Age: 18-64 years, 65+ years. Enrolment: 60.
Status: Ended. Start date (EU): 2024-11-18. End date (EU): 2026-05-04. Decision date: 2024-11-18. Results received: No. Last updated: 2024-11-18.

Condition(s): central nervous system (CNS) lymphomas
Product: Berubicin hydrochloride

Primary endpoint: To evaluate the safety and tolerability of Berubicin in combination with other cytostatic agents and to determine the recommended Phase 2 dose (RP2D) of Berubicin
Endpoint(s): To evaluate Progression Free Survival (PFS), defined as the time interval from the date of the first study drug administration to the date of first documentation of progressive disease (PD) or death (whichever occurs first) at 2 years in patients with Primary Central Nervous System Lymphoma and secondary Non-Hodgkin’s Lymphoma with CNS involvement treated with Berubicin-containing chemotherapeutic regimens, To assess overall response rate (ORR), defined as the proportion of participants who achieved a CR or PR at the end of therapy as assessed by the Investigator according to the most recent "Lugano Response Criteria for NHL" [1] or the "Response Criteria of the International Primary CNS Lymphoma Collaborative Group - IPCG" [2] criteria, To assess the effect of Berubicin on overall survival (OS) defined as the time interval from the date of the first study drug administration to the date of death at 2 years, Proportion of patients achieving CR at 12 months, Proportion of patients achieving PR at 12 months, To assess the effect of Berubicin on event-free survival (EFS), defined as the length of time from the initiation of study drug administration to disease progression, death, or discontinuation of treatment for any reason (e.g., toxicity, intolerance, disease-related conditions, or failure to respond), To evaluate the concentration of complement factors (C3, C4, C5), CRP protein, and circulating miRNA particles in subjects’ plasma and CSF fluid using genomic microarray assessment, To confirm the pharmacokinetic (PK) profile of Berubicin and its metabolite, berubicinol

Source: https://euclinicaltrials.eu/ctis-public/view/2024-516773-69-00